EU clinical trial 2024-511808-17-00: A research study of a new medicine NNC0363-1063 in healthy participants and participants with type 1 diabetes
Protocol code: NN1644-7794
Sponsor: Novo Nordisk A/S (Pharmaceutical company). Phase: Human Pharmacology (Phase I)- First administration to humans. Countries: Germany (ended).
Therapeutic area(s): Diseases [C] - Nutritional and Metabolic Diseases [C18]
Gender: Female, Male. Age: 18-64 years. Enrolment: 118.
Status: Ended. Start date (EU): 2024-10-31. End date (EU): 2026-03-18. Decision date: 2024-10-14. Results received: No. Last updated: 2025-12-29.

Condition(s): Type 1 diabetes mellitus

Source: https://euclinicaltrials.eu/ctis-public/view/2024-511808-17-00